EU clinical trial 2024-517377-24-00: Cardiac safety of treosulfan chemotherapy prior to stem cell transplantation in patients with leukemia.
Protocol code: MC-FludT.18/QT
Sponsor: Medac Gesellschaft fuer klinische Spezialpraeparate mbH (Pharmaceutical company). Phase: Human Pharmacology (Phase I)- Other. Countries: Germany (ended).
Therapeutic area(s): Diseases [C] - Hemic and Lymphatic Diseases [C15]
Gender: Female, Male. Age: 18-64 years, 65+ years. Enrolment: 30.
Status: Ended. Start date (EU): 2022-12-20. End date (EU): 2025-10-23. Decision date: 2024-10-18. Results received: No. Last updated: 2025-04-25.

Condition(s): Subjects with AML ( Acute myeloid leukaemia) or MDS (Myelodysplastic syndrome) undergoing allogeneic hematopoietic stem cell transplantation

Source: https://euclinicaltrials.eu/ctis-public/view/2024-517377-24-00